EU clinical trial 2025-521681-10-00: A Phase 2, Open-Label, Multicenter Study of Zoldonrasib(RMC-9805) in Previously Treated Patients with RAS G12DMutant Non-Small Cell Lung Cancer (NSCLC) – Subprotocol D
Protocol code: RMC-LUNG-101D
Sponsor: Revolution Medicines Inc. (Pharmaceutical company). Phase: Therapeutic exploratory (Phase II). Countries: Germany (ended), Greece (ended), Netherlands (ongoing, recruitment ended), Czechia (ended), France (ongoing, recruitment ended), Austria (ended), Denmark (ended), Spain (ongoing, recruitment ended), Italy (ongoing, recruitment ended).
Therapeutic area(s): Diseases [C] - Respiratory Tract Diseases [C08]
Gender: Female, Male. Age: 18-64 years, 65+ years. Enrolment: 91.
Start date (EU): 2025-10-02. Decision date: 2025-09-22. Results received: No. Last updated: 2026-06-12.
Decision dates by country: ES: 2025-09-25, CZ: 2025-09-24, DK: 2025-09-22, FR: 2025-09-26, AT: 2025-09-22, GR: 2025-09-25, IT: 2025-09-24, DE: 2025-09-24, NL: 2025-09-29

Condition(s): Lung Cancer
Product: RMC-9805

Primary endpoint: Confirmed ORR per RECIST v1.1 as assessed by BICR
Endpoint(s): •PFS, • OS, • DOR, • TTR, • DCR, • PFS rate at 6 months and 12 months and OS rate at 12 months, • Incidence of TEAEs, SAEs, and changes from baseline in clinical laboratory values and vital signs., • Zoldonrasib blood concentration over time

Source: https://euclinicaltrials.eu/ctis-public/view/2025-521681-10-00